EU clinical trial 2023-507878-41-00: Sequential Gilteritinib in Combination with Venetoclax and Azacitidine for Patients with Newly Diagnosed Acute Myeloid Leukemia and FLT3 Mutations Ineligible for Intensive Treatment (SEQUENCE)
Protocol code: TUD-SEQUNC-081
Sponsor: Technische Universitat Dresden (Educational Institution). Phase: Therapeutic exploratory (Phase II). Countries: Germany (ongoing, recruiting).
Therapeutic area(s): Diseases [C] - Neoplasms [C04]; Diseases [C] - Hemic and Lymphatic Diseases [C15]
Gender: Female, Male. Age: 18-64 years, 65+ years. Enrolment: 60.
Status: Ongoing, recruiting. Start date (EU): 2025-04-25. Decision date: 2024-08-26. Results received: No. Last updated: 2026-05-11.

Condition(s): Acute myeloid leukemia
Product: Venclyxto 100 mg film-coated tablets, AZACITIDINE, Xospata 40 mg film-coated tablets

Primary endpoint: Ratio of dose delivered/dose planned over the 12-cycle treatment period as evaluated at 12 months. This endpoint reflects both treatment efficacy (patients live longer event-free), and safety (less dose reductions, less omitted doses)
Endpoint(s): Ratio of dose delivered/dose planned over 2 cycles evaluated after 75 days, Complete hematologic remission/complete remission with partial hematologic recovery (CR/CRh), DOR, RFS, OS, CIR, Depth of response by MRD, Tolerability (Adverse events), Duration of cytopenias, transfusion dependence

Source: https://euclinicaltrials.eu/ctis-public/view/2023-507878-41-00